EU clinical trial 2023-508750-25-00: A Phase 3, Randomized, Double-blind, Placebo-controlled Study of Adenoassociated Virus Serotype 8-mediated Gene Transfer of Glucose-6-phosphatase in Patients With Glycogen Storage Disease Type Ia.
Protocol code: DTX401-CL301
Sponsor: Ultragenyx Pharmaceutical Inc. (Pharmaceutical company). Phase: Therapeutic confirmatory (Phase III). Countries: Denmark (ended), Netherlands (ended), Spain (ended), Italy (ended), Germany (ended).
Therapeutic area(s): Diseases [C] - Nutritional and Metabolic Diseases [C18]
Gender: Female, Male. Age: 0-17 years, 18-64 years, 65+ years. Enrolment: 30.
Status: Ended. Start date (EU): 2022-01-11. End date (EU): 2025-12-22. End date: 2026-02-20. Decision date: 2024-05-17. Results received: No. Last updated: 2026-01-19.
Decision dates by country: NL: 2024-05-17, ES: 2024-05-17, DK: 2024-05-17, DE: 2024-06-17, IT: 2024-05-29

Condition(s): Glycogen Storage Disease Type Ia (GSDIa)
Product: Prednisolon STADA® 5 mg Tabletten, Prednisolone placebo hard capsule, 10 mg, Prednisolone Placebo hard capsule, 5mg, Prednisolon STADA® 10 mg Tabletten, Pariglasgene brecaparvovec, Normal Saline

Primary endpoint: "Percent change from Baseline to Week 48 in daily cornstarch intake for the DTX401 Group compared with the Placebo Group."
Endpoint(s): "1. Change from Baseline to Week 48 in number of total daily doses of cornstarch 2. Change from Baseline to Week 48 in the percentage of glucose values in hypoglycemic range (<70 mg/dL [3.9 mmol/L]), assessed for noninferiority; if non-inferiority is established, the endpoint will be tested for superiority. 3. PGIC assessment score at Week 48. ", "4. Change from Baseline to Week 48 in time to hypoglycemia (<54 mg/dL [3.0 mmol/L]) during the CFC. 5. Change from Baseline to Week 48 in percentage of glucose values in the range of 70-120 mg/dL [3.9-6.7 mmol/L], assessed for noninferiority; if non-inferiority is established, the endpoint will be tested for superiority.", 6. Incidence, severity, and relationship to investigational product of TEAEs, TEAEs of special interest, serious TEAEs, related TEAEs, discontinuations from study or investigational product due to AEs, and fatal AEs.

Source: https://euclinicaltrials.eu/ctis-public/view/2023-508750-25-00